EU clinical trial 2025-520891-25-00: High Dose Dexamethasone in High-Pain-Responders Undergoing Enhanced Recovery Video-Assisted Thoracoscopic Surgery Lobectomy and Segmentectomy – A Randomized Double-Blinded Controlled Trial
Sponsor: Rigshospitalet (Hospital/Clinic/Other health care facility). Phase: Therapeutic exploratory (Phase II). Countries: Denmark (ongoing, recruiting).
Therapeutic area(s): Diseases [C] - Respiratory Tract Diseases [C08]; Analytical, Diagnostic and Therapeutic Techniques and Equipment [E] - Anesthesia and Analgesia [E03]
Gender: Female, Male. Age: 18-64 years, 65+ years. Enrolment: 80.
Status: Ongoing, recruiting. Start date (EU): 2025-08-28. Decision date: 2025-04-28. Results received: No. Last updated: 2025-07-14.

Condition(s): Lung cancer
Product: Dexavit, injektions-/infusionsvæske, opløsning

Primary endpoint: Pain when coughing on the morning on POD1 (Numeric Rating Scale 0-10)
Endpoint(s): Pain at 5-meter walk test in the morning and afternoon POD1+2 (NRS), Pain when coughing on the afternoon POD1 + morning and afternoon POD2 (NRS), Postoperative length of stay (in days), Cumulative use of rescue analgesics per day during POD1+2, Cumulative use of rescue antiemetics per day during POD1+2, Reasons for re-admission within 30 days (defined as overnight hospital stay after discharge), Intensive Care Unit Days, Pain Catastrophizing Scale (PCS), Morbidity and mortality (30-day), Quality of recovery questionnaire (QoR15) in day 7, Nausea (NRS), Episodes of vomiting

Source: https://euclinicaltrials.eu/ctis-public/view/2025-520891-25-00